EU clinical trial 2023-503868-16-00: A Phase III, Randomized, Open-Label, Multicenter Study of Lurbinectedin in Combination with Atezolizumab Compared with Atezolizumab as Maintenance Therapy in Participants with Extensive-Stage Small-Cell Lung Cancer (ES-SCLC) Following First-Line Induction Therapy with Carboplatin, Etoposide and Atezolizumab
Protocol code: GO43104
Sponsor: F. Hoffmann-La Roche AG (Pharmaceutical company). Phase: Therapeutic confirmatory (Phase III). Countries: Italy (ongoing, recruitment ended), Belgium (ongoing, recruitment ended), Hungary (ongoing, recruitment ended), Germany (ongoing, recruitment ended), Spain (ongoing, recruitment ended), Greece (ongoing, recruitment ended), Poland (ongoing, recruitment ended).
Therapeutic area(s): Health Care [N] - Environment and Public Health [N06]
Gender: Female, Male. Age: 18-64 years, 65+ years. Enrolment: 332.
Status: Ongoing, recruitment ended. Start date (EU): 2022-02-14. Decision date: 2024-07-02. Results received: No. Last updated: 2026-07-30.
Decision dates by country: BE: 2024-07-02, IT: 2024-07-08, GR: 2024-07-19, HU: 2024-07-02, PL: 2024-07-15, ES: 2024-07-05, DE: 2024-09-18

Condition(s): Small-Cell Lung Cancer (SCLC)
Product: Tecentriq 1 200 mg concentrate for solution for infusion, RO7508182, LURBINECTEDIN

Primary endpoint: 1. IRF-assessed progression-free survival (PFS) after randomization, defined as the time from randomization to the date of first occurrence of documented disease progression (as assessed by the IRF according to RECIST v1.1), or death from any cause (whichever occurs first), 2. Overall Survival after randomization, defined as the time from randomization to the date of death from any cause
Endpoint(s): 1. Investigator-assessed progression-free survival (PFS), 2. Confirmed objective response rate (ORR) as determined by the IRF and investigator according to RECIST v1.1, 3. Duration of response (DOR) as determined by the IRF and investigator according to RECIST v1.1, 4. PFS rates at 6 months and 12 months as determined by the IRF and investigator according to RECIST v1.1, 5. OS rates at 12 months and 24 months, 6. Incidence and severity of adverse events, including serious adverse events and adverse events of special interest in randomized participants, with severity determined according to National Cancer Institute Common Terminology Criteria for Adverse Events (NCI CTCAE) v5.0, 7. Prevalence of anti-drug antibodies (ADAs) to atezolizumab at induction phase baseline and incidence of ADAs to atezolizumab after drug administration by treatment group, 8. Time to confirmed deterioration (TTCD) from randomization in patient reported physical functioning and global health status as measured by the European Organisation for Research and Treatment of Cancer Quality of Life Questionnaire-Core 30 (EORTC QLQ-C30)

Source: https://euclinicaltrials.eu/ctis-public/view/2023-503868-16-00